EU clinical trial 2024-513471-40-00: Therapeutic approach of repeated transient blood-brain barrier opening in amyotrophic lateral sclerosis
Protocol code: APHP230845
Sponsor: Assistance Publique Hopitaux De Paris (Hospital/Clinic/Other health care facility). Phase: Phase I and Phase II (Integrated)- Other. Countries: France (authorised, recruitment pending).
Therapeutic area(s): Diseases [C] - Nervous System Diseases [C10]
Gender: Female, Male. Age: 18-64 years, 65+ years. Enrolment: 23.
Status: Authorised, recruitment pending. Decision date: 2025-03-19. Results received: No. Last updated: 2026-05-13.

Condition(s): Amyotrophic lateral Sclerosis

Source: https://euclinicaltrials.eu/ctis-public/view/2024-513471-40-00